EU clinical trial 2024-511681-37-00: Treatment with acetylcholine esterase inhibitors in anorexia nervosa : a multicenter double-blind randomised controlled trial versus placebo
Protocol code: D22-P020
Sponsor: Centre Hospitalier Sainte Anne Paris (Hospital/Clinic/Other health care facility). Phase: Therapeutic exploratory (Phase II). Countries: France (ongoing, recruiting).
Therapeutic area(s): Psychiatry and Psychology [F] - Mental Disorders [F03]
Gender: Female. Age: 18-64 years. Enrolment: 147.
Status: Ongoing, recruiting. Start date (EU): 2025-07-02. Decision date: 2024-06-14. Results received: No. Last updated: 2026-03-27.

Condition(s): Anorexia nervosa
Product: DONEPEZIL ARROW 5 mg, comprimé pelliculé, The placebo has the same container composition as the investigational medicinal product (exception of the active substance) and is manufactured by the same manufacturer (pui of the brest university hospital) according to the same procedures as the investigational medicinal product. the active substance is lactose monohydrate, ARICEPT 5 mg, comprimé pelliculé, DONEPEZIL BIOGARAN 5 mg, comprimé pelliculé

Primary endpoint: Absolute intra-individual difference in the total EDE-Q score obtained between inclusion D0 and D90, i.e. (EDE-Qd90 - EDE-Qd0)
Endpoint(s): Intra-individual difference in body mass index between inclusion D0 and D90, and between D0 and D180, Difference in intra-individual response rates (rate of responses) in the devalued condition of phase 3 "slip of action" of the HABITS neurocognitive test between D0 and D90., Intra-individual difference in Self-Report Habit Index (SRHI) scores at D0 and D90 (Davis et al IJED 2020)., Intra-individual difference between scores at D0 and D90 in the Wisconsin Card Sorting Test (WSCT), Trail Making Test B-A and Brixton test., Intra-individual difference in Yale-Brown Obsessive Compulsive Scale (Y-BOCS) scores at D0 and D90, Evolution of EDE-Q and EDI-3 sub-dimensions scores between inclusion D0 and D90, Intra-individual difference in Hospital Anxiety and Depression Scale (HADS) scores between D0 and D90, Evolution of the total EDE-Q score between inclusion D0, D90 and D180., Occurrence of adverse events measured according to a standard CTCAE, number of treatment discontinuations due to poor tolerance and changes in biological profile (elevation of transaminases, decrease in PT, prolongation of APTT, increase in CPK, and a disturbance in the blood count formula) performed at D3, D5, D30 and D90, Collection and storage of plasma and faeces at D1 and D90

Source: https://euclinicaltrials.eu/ctis-public/view/2024-511681-37-00